EU clinical trial 2023-507956-56-00: Long-Term Follow-Up of Subjects Treated With NTLA-2002
Protocol code: ITL-2002-CL-999
Sponsor: Intellia Therapeutics Inc. (Pharmaceutical company). Phase: Phase I and Phase II (Integrated)- Other. Countries: France (ongoing, recruiting), Netherlands (ongoing, recruiting), Germany (authorised, recruitment pending).
Therapeutic area(s): Diseases [C] - Congenital, Hereditary, and Neonatal Diseases and Abnormalities [C16]
Gender: Female, Male. Age: 18-64 years, 65+ years. Enrolment: 19.
Start date (EU): 2024-05-17. Decision date: 2023-11-03. Results received: No. Last updated: 2026-04-08.
Decision dates by country: FR: 2023-11-03, NL: 2024-03-29, DE: 2025-05-12

Condition(s): Hereditary Angioedema
Product: NTLA-2002

Primary endpoint: Incidence of treatment-related AEs;, incidence of treatment-related SAEs, incidence of treatment-related AESIs defined per protocol
Endpoint(s): - Rate of HAE attacks overall and rate of HAE attacks requiring acute therapy, - Total plasma kallikrein protein level, - Change from baseline in consumption of on demand HAE medications for attacks, - Change from baseline in healthcare utilization for HAE attacks, - Change from baseline in QoL parameters as measured by the MOXIE Angioedema QoL instrument, EQ-5D-5L, WPAI:GH, and WPAI:HAE

Source: https://euclinicaltrials.eu/ctis-public/view/2023-507956-56-00